EU clinical trial 2024-520078-36-00: A phase 1, controlled, open-label, single dose, dose-escalation, clinical proof-of-concept study of MRI enhanced with ADx-001 (DSPE-DOTA-Gd Liposomal Injection) in patients with brain amyloid deposits as demonstrated by amyloid PET
Protocol code: ADx-001-101-POC
Sponsor: Alzeca Biosciences Inc. (Pharmaceutical company). Phase: Human Pharmacology (Phase I)- First administration to humans. Countries: Germany (ended).
Therapeutic area(s): Diseases [C] - Nervous System Diseases [C10]
Gender: Female, Male. Age: 18-64 years, 65+ years. Enrolment: 18.
Status: Ended. End date (EU): 2025-08-08. End date: 2025-08-09. Decision date: 2025-01-17. Results received: No. Last updated: 2025-01-17.

Condition(s): Alzheimer's disease

Source: https://euclinicaltrials.eu/ctis-public/view/2024-520078-36-00